EU clinical trial 2024-515481-13-00: Multicenter clinical trial to evaluate the safety and feasibility of allogeneic tissue engineered product (human nanostructured artificial cornea) in patients with advanced corneal trophic ulcers refractory to (ophtalmic) conventional treatment.
Protocol code: CAH/Ulc/2010
Sponsor: Red Andaluza De Diseno Y Traslacion De Terapias Avanzadas Fundacion Publica Andaluza Progreso Y Salud (Hospital/Clinic/Other health care facility). Phase: Phase I and Phase II (Integrated)- First administration to humans. Countries: Spain (ongoing, recruitment ended).
Therapeutic area(s): Diseases [C] - Eye Diseases [C11]
Gender: Female, Male. Age: 18-64 years, 65+ years. Enrolment: 20.
Status: Ongoing, recruitment ended. Start date (EU): 2024-07-05. Decision date: 2024-07-05. Results received: No. Last updated: 2024-07-05.

Condition(s): Corneal trophic ulcers refractory to conventional treatment or sequelae of previous ulcers (such as stromal thinning or fibrosis), associated or not with limbal insufficiency of the same eye.
Product: Amniotic membrane, Alogenic sclerocorneal limbus stem adult limbal cells expanded combined with alogenic corneal diferenciated adult keratocytes expanded in biological matrix

Primary endpoint: Incidence of adverse events and severe adverse events related with the IMP., Graft conditions (artificial cornea): integrity, graft survival or reabsorption., Local, regional or systemic infection signs., Induced corneal vascularization.
Endpoint(s): Ulcer persistence or regeneration of corneal stroma., Visual acuity., Corneal transparency., Quality of life (EQ5, part I and II)., Characterization of corneal surface (impression citology & OCT mapping).

Source: https://euclinicaltrials.eu/ctis-public/view/2024-515481-13-00